EU clinical trial 2023-508821-28-00: Interventional, randomized, double-blind, parallel-group, placebo-controlled, dose-finding trial of Lu AG09222 for the prevention of migraine in participants with episodic and chronic migraine. Lundbeck trial no: 20297A
Protocol code: 20297A
Sponsor: H. Lundbeck A/S (Pharmaceutical company). Phase: Therapeutic exploratory (Phase II). Countries: Hungary (ended), Lithuania (ended), Slovakia (ended), Romania (ended), Czechia (ended), Poland (ended), Denmark (ended), Germany (ended), Bulgaria (ended), France (ended), Spain (ended).
Therapeutic area(s): Diseases [C] - Nervous System Diseases [C10]
Gender: Female, Male. Age: 18-64 years. Enrolment: 552.
Status: Ended. Start date (EU): 2024-08-14. End date (EU): 2026-03-16. End date: 2026-03-17. Decision date: 2024-07-22. Results received: No. Last updated: 2026-01-09.
Decision dates by country: LT: 2024-07-23, DE: 2024-07-26, BG: 2024-07-26, PL: 2024-07-23, SK: 2024-07-23, CZ: 2024-07-25, FR: 2024-11-15, DK: 2024-07-22, RO: 2024-07-26, ES: 2024-11-15, HU: 2024-07-24

Condition(s): Migraine
Product: Placebo to match IMP Lu AG09222

Primary endpoint: Change from baseline in Monthly Migraine Diary (Weeks 1-12) (efficacy)
Endpoint(s): Change from baseline in Monthly Migraine Diary (Weeks 1-12) (dose response), 50% Monthly Migraine Diary response: ≥50% reduction from baseline in Monthly Migraine Diaries (Weeks 1-12), 75% Monthly Migraine Diary response: ≥75% reduction from baseline in Monthly Migraine Diaries (Weeks 1-12), Change from baseline in Monthly Headache Days (Weeks 1-12), TEAEs, Changes from baseline in clinical safety laboratory test values, vital signs, weight, and ECG parameter values, PCS clinical safety laboratory test values, vital signs, weight changes, and ECG parameter values, Suicidal ideation and behaviour based on the C-SSRS, Development of ADAs, characterization of ADAs, and impact of ADA on PK, efficacy, and safety

Source: https://euclinicaltrials.eu/ctis-public/view/2023-508821-28-00